EU clinical trial 2023-510028-63-00: The effect of combining lidocaine and ropivacaine on the duration and onset time of an ultrasound-guided infraclavicular brachial plexus nerve block. A randomized controlled trial
Sponsor: Nordsjaellands Hospital (Hospital/Clinic/Other health care facility). Phase: Phase III and phase IV (Integrated). Countries: Denmark (ended).
Therapeutic area(s): Diseases [C] - Musculoskeletal Diseases [C05]; Analytical, Diagnostic and Therapeutic Techniques and Equipment [E] - Anesthesia and Analgesia [E03]
Gender: Female, Male. Age: 18-64 years, 65+ years. Enrolment: 1.
Status: Ended. Start date (EU): 2024-04-18. End date (EU): 2024-11-23. Decision date: 2024-03-22. Results received: No. Last updated: 2024-03-22.

Condition(s): Patients undergoing hand surgery for antebrachial fractures or arthroplasty/alloplasty of a thumb base joint in the hand
Product: Ropivacain Fresenius Kabi, Ropivacain Fresenius Kabi, Lidokain-adrenalin SAD, injektionsvæske, opløsning

Primary endpoint: Total time to breakthrough pain: From the completion of the LIC block to first sensation of pain from the surgical area
Endpoint(s): The onset of sensory block: From the completion of the LIC block to complete sensory blockade, Total duration of sensory blockade: From the completion of the LIC block until the ending of sensory blockade, Total duration of motor blockade: From the completion of the LIC block until the ending of motor blockade, Degree of motor blockade at sensory onset (at complete sensory blockade and 45 minutes after block performance)

Source: https://euclinicaltrials.eu/ctis-public/view/2023-510028-63-00